EU clinical trial 2025-523327-21-00: TRAMORNOT: Tramadol versus morphine in postoperative analgesia after laparoscopic abdominal surgery: a randomized controlled trial
Sponsor: Centre Hospitalier Universitaire Amiens Picardie (Hospital/Clinic/Other health care facility). Phase: Therapeutic use (Phase IV). Countries: France (authorised, recruitment pending).
Therapeutic area(s): Analytical, Diagnostic and Therapeutic Techniques and Equipment [E] - Anesthesia and Analgesia [E03]
Gender: Female, Male. Age: 18-64 years, 65+ years. Enrolment: 140.
Status: Authorised, recruitment pending. Decision date: 2025-12-22. Results received: No. Last updated: 2025-12-22.

Condition(s): Postoperative pain following scheduled major laparoscopic abdominal surgery
Product: Morphine Sulfate 10mg /ml Solution for Injection, Morfinesulfaat Sandoz 10 mg, tabletten, Tramadol 100 mg/ml oral drops, solution.

Primary endpoint: The primary endpoint is the multidimensional score validated in French assessing postoperative patient recovery: the QoR-15 (Quality of Recovery-15) score at 24 hours after surgery.
Endpoint(s): QoR-15 questionnaire scores at 48 and 72 hours, Mean postoperative pain NRS (0–10) scores in the Post-Anesthesia Care Unit (PACU), and at 24, 48, and 72 hours, Opioid consumption expressed in oral morphine equivalent at 24 and 72 hours postoperatively, Analgesic efficacy after opioid administration, assessed by NRS (0–10) two hours post opioid administration, Length of stay in the PACU (minutes) and total postoperative hospital stay (days), Occurrence of the following adverse effects after opioid use: nausea/vomiting, ileus, hypoxemia, pruritus, confusion (assessed by CAM tool), Pain management satisfaction score, evaluated on a numerical scale from 0 to 10 (0 = total dissatisfaction, 10 = total satisfaction) at hospital discharge, Number of patients consuming opioids daily at 1 and 3 months post-discharge, Misuse risk assessment using the POMI-5F scale, Presence of chronic post-surgical pain at 3 months after surgery

Source: https://euclinicaltrials.eu/ctis-public/view/2025-523327-21-00